EU clinical trial 2024-515996-37-00: Pressurized intraperitoneal aerosol chemotherapy (PIPAC) associated with systemic chemotherapy in women with advanced ovarian cancer
Sponsor: Hospices Civils De Lyon (Hospital/Clinic/Other health care facility). Phase: Human Pharmacology (Phase I)- Other. Countries: France (ongoing, recruiting).
Therapeutic area(s): Diseases [C] - Neoplasms [C04]
Gender: Female. Age: 18-64 years, 65+ years. Enrolment: 15.
Status: Ongoing, recruiting. Start date (EU): 2026-06-30. Decision date: 2024-08-07. Results received: No. Last updated: 2026-04-27.

Condition(s): peritoneal carcinosis of ovarian origin cancer

Source: https://euclinicaltrials.eu/ctis-public/view/2024-515996-37-00